EU clinical trial 2026-525448-14-00: Bioequivalence study 1 to compare pharmacokinetics of Parkinson´s disease drugs in healthy volunteers
Protocol code: 3135004
Sponsor: Orion Corporation (Pharmaceutical company). Phase: Human Pharmacology (Phase I)- Bioequivalence Study. Countries: Czechia (authorised, recruitment pending).
Therapeutic area(s): Diseases [C] - Nervous System Diseases [C10]
Gender: Female, Male. Age: 18-64 years. Enrolment: 40.
Status: Authorised, recruitment pending. Decision date: 2026-05-22. Results received: No. Last updated: 2026-05-22.

Condition(s): Parkinson disease

Source: https://euclinicaltrials.eu/ctis-public/view/2026-525448-14-00